EU clinical trial 2024-515415-22-00: First administration of a single and increasing doses of BDT272 to assess its safety and pharmacokinetic in healthy volunteers
Sponsor: Biodol Therapeutics (Pharmaceutical company). Phase: Human Pharmacology (Phase I)- First administration to humans. Countries: France (ended).
Therapeutic area(s): Diseases [C] - Nervous System Diseases [C10]
Gender: Female, Male. Age: 18-64 years. Enrolment: 84.
Status: Ended. Start date (EU): 2024-11-25. End date (EU): 2026-02-19. Decision date: 2024-11-08. Results received: No. Last updated: 2025-10-22.

Condition(s): Moderate to severe pain

Source: https://euclinicaltrials.eu/ctis-public/view/2024-515415-22-00